EU clinical trial 2023-503500-87-00: A Phase 3, Randomized, Double-blind, Placebo-controlled Clinical Trial to Study the Efficacy and Safety of Pembrolizumab (MK-3475) in Combination With Chemoradiotherapy (CRT) versus CRT Alone in Participants with Muscle-invasive Bladder Cancer (MIBC) (KEYNOTE-992)
Protocol code: MK-3475-992
Sponsor: Merck Sharp & Dohme LLC (Pharmaceutical company). Phase: Phase III and phase IV (Integrated). Countries: Netherlands (ongoing, recruitment ended), Spain (ongoing, recruitment ended), Romania (ongoing, recruitment ended), Poland (ongoing, recruitment ended), Latvia (ongoing, recruitment ended), Czechia (ongoing, recruitment ended), France (ongoing, recruitment ended), Portugal (ongoing, recruitment ended), Italy (ongoing, recruitment ended), Hungary (ongoing, recruitment ended), Estonia (ongoing, recruitment ended).
Therapeutic area(s): Diseases [C] - Neoplasms [C04]
Gender: Female, Male. Age: 18-64 years, 65+ years. Enrolment: 181.
Status: Ongoing, recruitment ended. Start date (EU): 2020-03-17. Decision date: 2023-06-06. Results received: No. Last updated: 2026-07-22.
Decision dates by country: PL: 2023-07-18, EE: 2023-07-05, RO: 2023-07-19, LV: 2023-07-21, NL: 2023-06-06, FR: 2023-06-26, HU: 2023-06-07, ES: 2023-06-08, IT: 2023-07-04, PT: 2023-06-14, CZ: 2023-06-19

Condition(s): Muscle Invasive Bladder Cancer
Product: Placebo to keytruda - normal saline, CISPLATIN, MITOMYCIN, GEMCITABINE, KEYTRUDA 25 mg/mL concentrate for solution for infusion, FLUOROURACIL

Primary endpoint: Bladder Intact Event-Free Survival (BI-EFS)
Endpoint(s): Overall Survival (OS), Metastasis-Free Survival (MFS), Time to Occurrence of Non–Muscle-Invasive Bladder Cancer (NMIBC), Number of Participants Who Experienced an Adverse Event (AE), Number of Participants Who Discontinued Study Intervention Due to an AE, Change from Baseline in the Global Health Status/Quality of Life (Items 29 and 30) Combined Score on the European Organization for Research and Treatment of Cancer Quality of Life Questionnaire-Core 30 (EORTC QLQ-C30), Change from Baseline in Physical Functioning (Items 1-5) Combined Score on the EORTC QLQ-C30, Change from Baseline in Urinary, Bowel, and Sexual Domains of the Bladder Cancer Index (BCI), Change from Baseline in the Visual Analog Score (VAS) of the European Quality of Life (EuroQoL)-5 Dimensions, 5-level Questionnaire (EQ-5D-5L), Time to Cystectomy

Source: https://euclinicaltrials.eu/ctis-public/view/2023-503500-87-00